EU clinical trial 2023-509787-15-00: PEACE 7 : A randomized Phase III trial with a factorial design evaluating the efficacy and safety of darolutamide and stereotactic dose escalated radiotherapy in patients with localized prostate cancer and high-risk features ofrelapse, from the Prostate Cancer Consortium in Europe (PEACE).
Protocol code: UC-GTG-2310
Sponsor: Unicancer (Hospital/Clinic/Other health care facility). Phase: Therapeutic confirmatory (Phase III). Countries: France (ongoing, recruiting), Spain (authorised, recruiting).
Therapeutic area(s): Diseases [C] - Neoplasms [C04]
Gender: Male. Age: 18-64 years, 65+ years. Enrolment: 600.
Start date (EU): 2025-02-17. Decision date: 2024-05-27. Results received: No. Last updated: 2026-07-09.
Decision dates by country: FR: 2024-05-27, ES: 2024-11-27

Condition(s): Patients with localised prostate cancer and high-risk features of relapse (minimum 2 high-risk criteria from National Comprehensive Cancer Network (NCCN) classification)1 and with no detectable metastasis, including no evidence of pelvic lymph node metastasis on next-generation imaging (PSMA PET/CT).
Product: NUBEQA 300 mg film-coated tablets, TRIPTORELIN, BAY 1841788

Primary endpoint: Metastasis-free survival (MFS)
Endpoint(s): Clinical Progression-Free Survival (cPFS), Biochemical Progression-Free Survival, Time to local relapse, Overall Survival (OS), Prostate Cancer-Specific Survival (PCSS), Severity of the adverse events and toxicities, Long-term toxicity, Quality of Life

Source: https://euclinicaltrials.eu/ctis-public/view/2023-509787-15-00